EU clinical trial 2023-504540-33-00: A Phase 3 Randomized, Double-Blind, Placebo-Controlled Study to Evaluate the Efficacy and Safety of Bemnifosbuvir in High-Risk Outpatients with COVID-19
Protocol code: AT-03A-017
Sponsor: Atea Pharmaceuticals Inc. (Pharmaceutical company). Phase: Therapeutic confirmatory (Phase III). Countries: Latvia (ended), Netherlands (ended), Sweden (ended), Spain (ended), Germany (ended), Romania (ended).
Therapeutic area(s): Diseases [C] - Virus Diseases [C02]
Gender: Female, Male. Age: 0-17 years, 18-64 years, 65+ years. Enrolment: 354.
Status: Ended. Start date (EU): 2023-03-06. End date (EU): 2024-05-06. End date: 2024-05-30. Decision date: 2023-07-18. Results received: Yes. Last updated: 2024-04-09.
Decision dates by country: DE: 2023-08-08, NL: 2023-07-20, RO: 2023-08-24, LV: 2023-07-18, SE: 2023-07-18, ES: 2023-07-19

Condition(s): COVID-19
Product: Paxlovid 150 mg + 100 mg film-coated tablets, Paxlovid 150 mg + 100 mg film-coated tablets, Placebo to match Bemnifosbuvir Hemisulfate, Bemnifosbuvir Hemisulfate

Primary endpoint: The primary efficacy endpoint is the proportion of subjects in the supportive-care-only population who are hospitalized for any cause or died due to any cause through Day 29
Endpoint(s): Proportion of subjects with COVID-19-related hospitalization or who died due to any cause through Day 29, Proportion of subjects who died due to any cause through Day 29 and Day 60, Proportion of subjects with COVID-19-related complications (e.g., death, hospitalization, radiologically confirmed pneumonia, acute respiratory failure, sepsis, coagulopathy, pericarditis/myocarditis, cardiac failure) through Day 29, Proportion of subjects with COVID-19-related medically attended visits (hospitalization, emergency room (ER) visit, urgent care visit, physician's office visit, or telemedicine visit) or who died due to any cause through Day 29 and Day 60, Proportion of subjects with COVID-19 symptom relapse through Day 29, Proportion of subjects with viral load rebound through Day 29, The incidence and severity of adverse events (AEs) and serious adverse events (SAEs)

Source: https://euclinicaltrials.eu/ctis-public/view/2023-504540-33-00